EU clinical trial 2026-525272-25-00: Prospective trial of [18F]AlF-FAPI-74 for PET imaging of fibroblast activation protein in patients with endometriosis
Sponsor: UZ Leuven (Hospital/Clinic/Other health care facility). Phase: Therapeutic exploratory (Phase II). Countries: Belgium (authorised, recruitment pending).
Therapeutic area(s): Diseases [C] - Female Urogenital Diseases and Pregnancy Complications [C13]
Gender: Female. Age: 18-64 years. Enrolment: 64.
Status: Authorised, recruitment pending. Decision date: 2026-07-10. Results received: No. Last updated: 2026-07-10.

Condition(s): endometriosis
Product: Buscopan 20 mg/1 ml oplossing voor injectie

Primary endpoint: Evaluation of the diagnostic performance of [18F]AlF-FAPI-74 PET/CT as a non-invasive tool to diagnose deep infiltrating endometriosis and/or superficial peritoneal endometriosis, in comparison with intra-operative laparoscopic findings (current gold-standard) in women with suspected endometriosis. The diagnostic performance is evaluated by correlating the locations of endometriotic lesions on [18F]AlF-FAPI-74 PET/CT and the locations of endometriotic lesions detected during laparoscopy., Additional primary endpoints related to the clinical investigational NeuroEXPLORER device: See Master Protocol EUDAMED_CIV-25-06-053398.
Endpoint(s): Sensitivity, specificity, positive predictive value, negative predictive value, accuracy of [18F]AlF-FAPI-74 PET/CT in detecting endometriotic lesions., Semi-quantitative uptake measurements (maximal standardized uptake value (SUVmax), average SUV (SUVmean), peak SUV (SUVpeak) of endometriotic lesions on [18F]AlF-FAPI-74 PET/CT., Endometriotic lesion-to-background uptake values (SUV lesion divided by SUV background) for [18F]AlF-FAPI-74 PET/CT, using following background organs: liver, lung, gluteus muscle, mediastinal bloodpool, bowel, bone marrow (L4 if no abnormal uptake)., Total FAP-positive endometriotic burden, defined as the sum of the volumes of all lesions deemed to be endometriotic in nature., Number of additional endometriotic lesions recorded after unblinding of the surgeon during laparoscopy., Diagnostic performance of MRI in detecting endometriotic lesions, in patients in which MRI is available, and comparison with [18F]AlF-FAPI-74 PET/CT, laparoscopy and if available ultrasound., Diagnostic performance of ultrasound in detecting endometriotic lesions, in patients in which ultrasound is available, and comparison with [ 18F]AlF-FAPI-74 PET/CT, laparoscopy and if available MRI., Impact on clinical management., Psychological impact on patient of [18F]AlF-FAPI-74 PET/CT procedure., Intra- and interobserver reproducibility of [18F]AlF-FAPI-74 PET/CT., Patient safety: adverse events of [18F]AlF-FAPI-74 PET/CT., Correlation of [18F]AlF-FAPI-74 biodistribution with FAP tissue expression as measured by immunohistochemistry (IHC)., Evolution of [18F]AlF-FAPI-74 PET/CT scans in patients initiating GnRH-agonist or GnRH-antagonist medication and receiving 2 [18F]AlF-FAPI-74 PET/CT (prior and post initiation of GnRH-agonist or GnRH-antagonist medication) : (i) number of lesion; (ii) uptake; (iii) endometriotic lesion-to-background value; (iv) correlation with laparoscopy and if available MRI and/or ultrasound., Additional secondary endpoints related to the clinical investigational NeuroEXPLORER device: See Master Protocol EUDAMED_CIV-25-06-053398.

Source: https://euclinicaltrials.eu/ctis-public/view/2026-525272-25-00